EU clinical trial 2024-519854-35-00: Evaluation of a modified Anti-Platelet Therapy associated with low-dose rapamycin DES Firehawk in Acute Myocardial Infarction Patients treated with complete revascularization strategy (TARGET-FIRST)
Protocol code: SFHI01
Sponsor: SORIN CRM SAS (Microport CRM) (Industry). Phase: Therapeutic use (Phase IV). Countries: Spain (ended), Netherlands (ended), Italy (ended).
Therapeutic area(s): Diseases [C] - Cardiovascular Diseases [C14]
Gender: Female, Male. Age: 18-64 years, 65+ years. Enrolment: 695.
Status: Ended. Start date (EU): 2021-06-29. End date (EU): 2025-03-24. Decision date: 2025-01-15. Results received: Yes. Last updated: 2025-04-14.
Decision dates by country: IT: 2025-04-14, ES: 2025-01-16, NL: 2025-01-15

Condition(s): Acute Myocardial Infarction
Product: Efient 10 mg film-coated tablets., Brilique 90 mg film-coated tablets, Plavix 75 mg film-coated tablets, ASPIRINE PROTECT 100 mg, comprimé gastro-résistant

Primary endpoint: Net Adverse Clinical and Cerebral Events (NACCE) defined as a composite of all cause death, non-fatal myocardial infarction, definite/probable stent thrombosis, stroke, or Bleeding Academic Research Consortium (BARC) type 3 or 5 bleeding at 11 months post randomization (12 months post index procedure).
Endpoint(s): The main secondary endpoint is BARC type 2, 3 or 5 bleeding events at 11 months post-randomization.

Source: https://euclinicaltrials.eu/ctis-public/view/2024-519854-35-00